EU clinical trial 2024-517334-18-00: Glucocorticoid withdrawal and glucocorticoid-induced adrenal insufficiency: a randomized controlled multicenter trial
Protocol code: TOASST
Sponsor: Kantonsspital Baden AG (Hospital/Clinic/Other health care facility). Phase: Therapeutic use (Phase IV). Countries: Germany (ongoing, recruiting).
Therapeutic area(s): Diseases [C] - Immune System Diseases [C20]
Gender: Female, Male. Age: 18-64 years, 65+ years. Enrolment: 25.
Status: Ongoing, recruiting. Start date (EU): 2022-04-06. Decision date: 2024-11-19. Results received: No. Last updated: 2026-06-29.

Condition(s): Inflammatory or autoimmune disorders
Product: PREDNISONE, P-Tabletten weiß 7 mm Lichtenstein, Marketing authorisation number: 6866372.00.00, ATC-Code: V03AX10.

Primary endpoint: Time to first occurrence of hospitalization, death, initiation of unplanned systemic glucocorticoid therapy, or adrenal crisis (defined as glucocorticoid-responsive hypotension or shock with or without accompanying symptoms and signs such as weakness, apathy, nausea, vomiting, abdominal pain, hypothermia, hyponatremia [serum sodium < 135 millimole (mM)], hyperkalemia [serum potassium > 5 mM], hypoglycemia [plasma glucose < 3.5 mM]); whichever occurs first.
Endpoint(s): Time to first occurrence of individual components of the primary outcome, Cumulative overall systemic glucocorticoid dose, Cumulative systemic glucocorticoid dose administered to treat or prevent adrenal failure, Cumulative systemic glucocorticoid dose administered to treat relapse of disease, specified for each disease, General health status as self-assessed by the participant on a visual analog scale (VAS) from 0 to 100, Score of symptoms and signs of hypocortisolism: weakness, hypothermia, nausea, vomiting, abdominal pain, fatigue, dizziness, and blood pressure, Performance in 250 mcg ACTH (Synacthen®) test, In patients hospitalized at study entry: length of hospital stay

Source: https://euclinicaltrials.eu/ctis-public/view/2024-517334-18-00